EU clinical trial 2024-511293-74-01: Anti-CD19 CAR T-Cell TherApy in Refractory Systemic Autoimmune DISeases - CATARSIS
Protocol code: RF-2021-12375251
Sponsor: Fondazione Policlinico Universitario Agostino Gemelli IRCCS (Hospital/Clinic/Other health care facility). Phase: Phase I and Phase II (Integrated)- Other. Countries: Italy (ongoing, recruiting).
Therapeutic area(s): Diseases [C] - Immune System Diseases [C20]
Gender: Female, Male. Age: 18-64 years, 65+ years. Enrolment: 8.
Status: Ongoing, recruiting. Start date (EU): 2024-11-26. Decision date: 2024-08-20. Results received: No. Last updated: 2025-10-10.

Condition(s): Refractory Systemic Autoimmune Diseases
Product: TOCILIZUMAB, CYCLOPHOSPHAMIDE, CD19-CAR_Lenti, FLUDARABINE, LEVETIRACETAM

Primary endpoint: - Incidence and grading of severity (graded 0-4) of Cytokine Release Syndrome (CRS) and of CAR T cell Associated Neurotoxicity Syndrome (ICANS) within the first 4 weeks after ATMP administration. - Incidence and severity of infections and leukopenia and/or hypogammaglobulinemia during the entire study period.
Endpoint(s): a) Duration of B cell depletion in the peripheral blood: CD19+ B cells assessed by fluorescence- activated cell sorting (FACS) equal to 0 up to week 24 and long-term FU. b) Duration of persistence of CAR T cells in the peripheral blood: CAR+ CD3+ cells assessed by FACS > 0 up to week 24 and long-term FU. c) Changes in the levels of disease-associated serum autoantibodies at week 24 including incidence of seroconversion (anti-dsDNA < LLN; ANA <1.100; all others “negative”) o SLE

Source: https://euclinicaltrials.eu/ctis-public/view/2024-511293-74-01